EU clinical trial 2025-522345-21-00: Pharmacokinetic, Safety, Tolerability, and Immunogenicity Comparison of CKD-704 (risankizumab biosimilar), with EU-approved Skyrizi®, and US licensed Skyrizi® in Healthy Adult Participants
Protocol code: A148_01PK2408
Sponsor: Chong Kun Dang Pharmaceutical Corp. (Pharmaceutical company). Phase: Human Pharmacology (Phase I)- First administration to humans. Countries: Poland (ongoing, recruitment ended).
Therapeutic area(s): Diseases [C] - Immune System Diseases [C20]
Gender: Female, Male. Age: 18-64 years. Enrolment: 213.
Status: Ongoing, recruitment ended. Start date (EU): 2025-11-11. Decision date: 2025-10-26. Results received: No. Last updated: 2025-12-15.

Condition(s): Active psoriatic arthritis, Moderately to severely active Crohn’s disease, Moderate-to-severe plaque psoriasis, Moderately to severely active ulcerative colitis

Source: https://euclinicaltrials.eu/ctis-public/view/2025-522345-21-00